EU clinical trial 2024-514948-89-00: An Open-Label Phase I/II Study of Relatlimab (BMS-986016) with Nivolumab (BMS-936558) in Combination with 5-Azacytidine for Relapsed/Refractory Acute Myeloid Leukemia and in Combination with 5-Azacytidine and Venetoclax for Newly Diagnosed, Previously Untreated Patients with Acute Myeloid Leukemia Negative for NPM1 and IDH 1/2 Mutations Who Are Ineligible for Intensive Chemotherapy (AARON)
Protocol code: CA224-065
Sponsor: Klinikum der Universitaet Muenchen AöR (Hospital/Clinic/Other health care facility). Phase: Phase I and Phase II (Integrated)- Other. Countries: Germany (ended).
Therapeutic area(s): Diseases [C] - Neoplasms [C04]; Diseases [C] - Hemic and Lymphatic Diseases [C15]
Gender: Female, Male. Age: 18-64 years, 65+ years. Enrolment: 30.
Status: Ended. Start date (EU): 2021-01-27. End date (EU): 2026-03-30. Decision date: 2024-10-02. Results received: No. Last updated: 2025-05-28.

Condition(s): Acute Myeloid Leukemia
Product: VENETOCLAX, Vidaza 25 mg/ml powder for suspension for injection, VENETOCLAX, OPDIVO 10 mg/mL concentrate for solution for infusion., VENETOCLAX, RELATLIMAB

Primary endpoint: Lead-in phase I: MTD and DLT of relatlimab in combination with nivolumab and 5-azacytidine in patients with R/R AML., Lead-in phase I: MTD and DLT of relatlimab in combination with nivolumab and 5-azacytidine and venetoclax in frontline non-fit AML patients., Expansion phase II: ORR to treatment with relatlimab + nivolumab + 5- azacytidine in patients with R/R AML., Expansion phase II: ORR to treatment with relatlimab + nivolumab + 5- azacytidine + venetoclax in frontline non-fit AML patients.
Endpoint(s): % of grade I/II and grade III/IV toxicities for patients with R/R AML on therapy with relatlimab + nivolumab + 5- azacytidine., % of grade I/II and grade III/IV toxicities for frontline non-fit AML patients on therapy with relatlimab + nivolumab + 5- azacytidine + venetoclax., Number of patients with R/R AML who achieve a HI in platelets, hemoglobin, or ANC on therapy with relatlimab + nivolumab + 5-azacytidine., Number of patients with R/R AML who achieve ≥50% reduction in blasts on therapy with relatlimab + nivolumab + 5-azacytidine., Number of frontline non-fit AML patients who have an HI in platelets, hemoglobin, or ANC on therapy with relatlimab + nivolumab + 5-azacytidine + venetoclax., Number of frontline non-fit AML patients who have ≥50% reduction in blasts on therapy with relatlimab + nivolumab + 5-azacytidine + venetoclax., Duration of response, Disease-free survival (DFS), and Overall Survival (OS) of patients with R/R AML treated with relatlimab + nivolumab + 5-azacytidine., Duration of response, DFS, and OS in frontline non-fit AML patients treated with relatlimab + nivolumab + 5-azacytidine + venetoclax.

Source: https://euclinicaltrials.eu/ctis-public/view/2024-514948-89-00